EU clinical trial 2022-500252-28-00: Randomized, placebo-controlled, double blind, multi-centre Phase IIb stuDy to evaluate the efficacy and safety of HepaStem in patients with Acute on Chronic Liver Failure (ACLF) – DHELIVER
Protocol code: HEP102
Sponsor: Cellaïon SA (Pharmaceutical company). Phase: Therapeutic exploratory (Phase II). Countries: Denmark (ended), Poland (ended), Bulgaria (ended), Netherlands (ended), Slovakia (ended), Latvia (ended), Lithuania (ended), Germany (ended), Belgium (ended), Austria (ended), France (ended), Estonia (ended), Italy (ended), Spain (ended).
Therapeutic area(s): Diseases [C] - Digestive System Diseases [C06]
Gender: Female, Male. Age: 18-64 years, 65+ years. Enrolment: 132.
Status: Ended. Start date (EU): 2019-12-17. End date (EU): 2024-05-10. Decision date: 2022-07-26. Results received: Yes. Last updated: 2023-10-13.
Decision dates by country: BE: 2022-07-28, AT: 2022-07-26, BG: 2022-07-26, DK: 2022-07-26, FR: 2022-07-26, IT: 2022-07-27, ES: 2022-07-29, EE: 2022-07-27, DE: 2022-07-27, LV: 2022-07-26, LT: 2022-07-27, NL: 2022-08-01, PL: 2022-08-01, SK: 2022-07-26

Condition(s): Cirrhotic patients who are hospitalized for Acute on chronic liver failure (ACLF), ACLF combines an acute deterioration of liver function in an individual with pre-existing chronic liver disease and extrahepatic organ failures characterized by high short-term mortality (30-40% at 28 days). The development of ACLF is associated with exacerbated systemic inflammation that may indeed cause organ failures.
Product: HepaStem, HepaStem Placebo

Primary endpoint: Survival at Day 90: Whether the patients are still alive will be recorded up to Day 90. Time and reason of death will be recorded.
Endpoint(s): Liver transplant-free survival (TFS) at Day 90., TFS at Day 90 while free of ACLF., TFS at Day 90 with MELD-Na score below 15., Duration of overall hospitalization and hospitalization in ICU and non- ICU during the index hospitalization up to Day 90., Number, nature, severity, seriousness and relationship of AEs during the whole study. This includes but is not limited to clinically changes in clinical examinations, vital signs, laboratory tests, and imaging., Occurrence of systemic infection (sepsis shock, bacteremia, invasive fungal infection)., Presence of anti-HLA Abs and donor-specific Abs (DSA) (thresholds more 1500 mean fluorescence intensity [MFI] and more than 5000 MFI)., Quantitative measurement of coagulation parameters: PT, INR, aPTT, fibrinogen, platelets, D-dimer., Any change in laboratory data at all visits, including data on serology, hematology, biochemistry. Abnormal laboratory results will only constitute an AE, and will be reported as such, if they are considered abnormal within the pathology of this study population., Physical examination and vital signs at all visits.

Source: https://euclinicaltrials.eu/ctis-public/view/2022-500252-28-00